EU clinical trial 2024-512236-30-00: SPARE : Evaluation of a therapeutic strategy to reduce the duration of antibiotic therapy for community-acquired alveolar pneumonia in children: a randomized controlled non-inferiority trial
Protocol code: RECHMPL22_0399
Sponsor: Centre Hospitalier Universitaire De Montpellier (Hospital/Clinic/Other health care facility). Phase: Therapeutic confirmatory (Phase III). Countries: France (authorised, recruitment pending).
Therapeutic area(s): Diseases [C] - Respiratory Tract Diseases [C08]
Gender: Female, Male. Age: 0-17 years. Enrolment: 1100.
Status: Authorised, recruitment pending. Decision date: 2024-08-30. Results received: No. Last updated: 2024-08-30.

Condition(s): Community-acquired alveolar pneumonia in children
Product: AMOXICILLIN TRIHYDRATE

Primary endpoint: The rate of therapeutic failure on day 7 (D7) defined by: - A change in antibiotherapy necessary before D7 due to a lack of satisfactory clinical response or clinical deterioration of the pneumonia. - A decision to resume or continue antibiotic therapy after D7 in connection with the pneumonia. - Hospitalization or death due to clinical deterioration related to community-acquired pneumonia.
Endpoint(s): Therapeutic failure rate on Day 30 (D30), defined by: - The occurrence of hospitalization linked to the initial episode. - An abnormal check-up chest x-ray at 1 month with persistent pneumonia. - The occurrence of complications of pneumonia (severe sepsis, pleurisy, pulmonary sequelae). - Relapse, defined by the development of signs of pneumonia 6 to 14 days after the respiratory rate returns to normal., Adverse effects attributable to antibiotics during and after taking amoxicillin, up to D30, Compliance throughout the duration of antibiotic therapy, up to D7 or D30 maximum, The duration of antibiotic therapy collected at visits on D7 and D30

Source: https://euclinicaltrials.eu/ctis-public/view/2024-512236-30-00